EU clinical trial 2024-516556-17-00: Multicentre Evaluation of Clinical Applications of Innovative PET/MRI with a 68Ga-PSMA-11 Radiotracer when Planning a Personalised Therapy in Prostate Cancer Patients
Protocol code: 2020/ABM/01/00074
Sponsor: Medical University Of Bialystok (Educational Institution). Phase: Therapeutic confirmatory (Phase III). Countries: Poland (ended).
Therapeutic area(s): Diseases [C] - Neoplasms [C04]
Gender: Male. Age: 18-64 years, 65+ years. Enrolment: 366.
Status: Ended. Start date (EU): 2022-12-12. End date (EU): 2026-03-31. Decision date: 2024-12-03. Results received: No. Last updated: 2024-12-03.

Condition(s): Intermediate and high-risk prostate cancer
Product: PSMA-11 kit for Ga-68 labelling

Primary endpoint: Percentage of patients for whom, following 68Ga-PSMA-11 PET/CT and 68Ga-PSMA-11 PET/MRI and precise location of neoplastic lesions, prostate cancer staging was changed according to ISUP and TNM classification, Percentage of patients, in whom, with 68Ga-PSMA PET/MRI and 68Ga-PSMA location of prostate cancer relapse was detected (detection rate) – Study Group 2 only
Endpoint(s): Percentage of patients, in whom 68Ga-PSMA-11 PET/CT and 68Ga-PSMA-11 PET/MRI prompts an alteration of the treatment plan, Percentage of patients, in whom 68Ga-PSMA-11 PET/CT and 68Ga-PSMA-11 PET/MRI prompts finding of the relapse location (Group 2 only), PSA levels, with which the relapse location was found with 68Ga-PSMA-11 PET/MRI (Group 2 only), Number and type of serious adverse effects reported during 68Ga-PSMA-11 PET/CT and 68Ga-PSMA-11 PET/MRI, Mean absorbed radiation dose during 68Ga-PSMA-11 PET/CT and 68Ga-PSMA-11 PET/MRI, Pharmacoeconomic data (cost of procedures planned to be performed after visit 1 and those actually performed after the investigated diagnostics were carried out)

Source: https://euclinicaltrials.eu/ctis-public/view/2024-516556-17-00